EU clinical trial 2024-516691-14-00: Phase I/II, First in Human, Dose Escalation Trial of TL-895 Monotherapy in Subjects with Relapsed/Refractory B-Cell Malignancies and Expansion of TL-895 Monotherapy and Combination Therapy with Navtemadlin in Treatment-Naïve Chronic Lymphocytic Leukemia or Small Lymphocytic Lymphoma Subjects and Subjects with Relapsed/Refractory Chronic Lymphocytic Leukemia or Relapsed/Refractory Small Lymphocytic Lymphoma
Protocol code: MS200662_0001
Sponsor: Telios Pharma Inc. (Pharmaceutical company). Phase: Phase I and Phase II (Integrated)- First administration to humans. Countries: Hungary (ended), Poland (ended).
Therapeutic area(s): Diseases [C] - Neoplasms [C04]
Gender: Female, Male. Age: 18-64 years, 65+ years. Enrolment: 69.
Status: Ended. Start date (EU): 2021-01-05. End date (EU): 2025-07-30. End date: 2025-07-31. Decision date: 2024-12-14. Results received: No. Last updated: 2025-05-09.
Decision dates by country: HU: 2024-12-14, PL: 2024-12-16

Condition(s): B Cell Malignancies and Chronic Lymphocytic Leukemia or Small Lymphocytic Lymphoma
Product: TL-895, TL-895

Primary endpoint: Dose Expansion, Part 2 - ORR, defined as the proportion of subjects achieving CR, CRi, nodular partial response (nPR), partial response (PR), or PR with lymphocytosis (PR-L) at any time while on the study based on iwCLL response criteria, as assessed by investigators.
Endpoint(s): CR/CRi rate, defined as the proportion of subjects achieving CR/CRi based on iwCLL response criteria, DOR, defined as time from initial response to disease progression or death from any cause, Analyses of the safety and tolerability endpoints will include the following measurements or assessments: − Incidence, nature, severity of treatment-emergent AEs (TEAEs), and deaths, including the cause of death, from Screening up to the End of Treatment visit − Clinical laboratory measurements, ECG measures, vital signs, ECOG performance status from Screening up to the End of Treatment visit, • TL-895 PK parameters, including but not limited to: − Predose concentration (C0h) − Concentration at 2 hours post-dose (C2h) − Cmax − Tmax − AUC, BTK occupancy in PBMCs

Source: https://euclinicaltrials.eu/ctis-public/view/2024-516691-14-00